EU clinical trial 2024-513852-13-00: A Randomized, Open-label Phase 3 Study of Amivantamab and mFOLFOX6 or FOLFIRI Versus Cetuximab and mFOLFOX6 or FOLFIRI as First-line Treatment in Participants With KRAS/NRAS and BRAF Wild-type Unresectable or Metastatic Left-sided Colorectal Cancer
Protocol code: 61186372COR3001
Sponsor: Janssen Cilag International (Pharmaceutical company). Phase: Therapeutic confirmatory (Phase III). Countries: Sweden (ongoing, recruiting), Italy (ongoing, recruiting), Germany (ongoing, recruiting), Belgium (ongoing, recruiting), Netherlands (ongoing, recruiting), Poland (ongoing, recruiting), Spain (ongoing, recruiting), France (ongoing, recruiting), Hungary (ongoing, recruiting).
Therapeutic area(s): Diseases [C] - Neoplasms [C04]
Gender: Female, Male. Age: 18-64 years, 65+ years. Enrolment: 266.
Status: Ongoing, recruiting. Start date (EU): 2025-01-20. Decision date: 2024-12-11. Results received: No. Last updated: 2026-06-23.
Decision dates by country: BE: 2024-12-11, SE: 2024-12-13, IT: 2024-12-16, DE: 2024-12-13, HU: 2024-12-18, PL: 2024-12-20, ES: 2024-12-11, NL: 2024-12-18, FR: 2024-12-12

Condition(s): KRAS/NRAS and BRAF Wild-type Unresectable or Metastatic Left-sided Colorectal Cancer
Product: Erbitux 5 mg/mL solution for infusion, JNJ-61186372, Erbitux 5 mg/mL solution for infusion

Primary endpoint: PFS (using RECIST v1.1), as assessed by BICR

Source: https://euclinicaltrials.eu/ctis-public/view/2024-513852-13-00